EU clinical trial 2023-509575-16-00: Low-Intervention Clinical Trial Evaluating a Novel Cytokine Release Assay for Tick-Borne Encephalitis (TBE) Among Healthy and Immunosuppressed Research Participants
Protocol code: 2023-509575-16-00
Sponsor: Vaestra Goetalandsregionen (Hospital/Clinic/Other health care facility). Phase: Therapeutic use (Phase IV). Countries: Sweden (ongoing, recruiting).
Therapeutic area(s): Diseases [C] - Virus Diseases [C02]
Gender: Female, Male. Age: 18-64 years, 65+ years. Enrolment: 100.
Status: Ongoing, recruiting. Start date (EU): 2024-08-19. Decision date: 2024-05-17. Results received: No. Last updated: 2025-02-07.

Condition(s): Tick-borne encephalitis
Product: FSME-IMMUN Vuxen, injektionsvätska, suspension i förfylld spruta Vaccin mot fästingburen encefalit (helvirus inaktiverat), Encepur (0,5 ml) Injektionsvätska, suspension, i förfylld spruta Vaccin mot fästingburen encefalit (TBE), inaktiverat

Primary endpoint: Concentrations of cytokines detected using our novel rapid release assay (T-cell assay) for TBE in relation to antibody responses (B-cell assays) as measured by commercially available assays.
Endpoint(s): The duration of detectable T- and B-cell immune responses directed against TBEV after infection with TBE., The duration of detectable T- and B-cell immune responses directed against TBEV after vaccination against TBE., Are cross-reactive T- and B-cell immune responses directed against TBEV detectable after prior vaccination against other flaviviruses, e.g., Yellow Fever and Japanese Encephalitis, and if so, are these responses transient or persistent?

Source: https://euclinicaltrials.eu/ctis-public/view/2023-509575-16-00